EU clinical trial 2025-521037-86-00: A multicenter, multinational, randomized, double-blind, placebo-controlled Phase 3, maintenance study to evaluate the efficacy and safety of duvakitug in participants with moderately to severely active Crohn’s disease
Protocol code: EFC18327
Sponsor: Sanofi-Aventis Recherche & Developpement (Pharmaceutical company). Phase: Therapeutic confirmatory (Phase III). Countries: Spain (authorised, recruitment pending), Czechia (authorised, recruitment pending), Lithuania (authorised, recruitment pending), Hungary (authorised, recruitment pending), Greece (authorised, recruitment pending), Bulgaria (ongoing, recruiting), Poland (authorised, recruitment pending), Belgium (authorised, recruitment pending), France (authorised, recruitment pending), Germany (ongoing, recruiting), Norway (authorised, recruitment pending), Austria (authorised, recruitment pending), Netherlands (authorised, recruitment pending), Italy (authorised, recruitment pending), Slovakia (authorised, recruitment pending).
Therapeutic area(s): Diseases [C] - Immune System Diseases [C20]
Gender: Female, Male. Age: 0-17 years, 18-64 years, 65+ years. Enrolment: 204.
Start date (EU): 2026-07-22. Decision date: 2026-02-24. Results received: No. Last updated: 2026-07-16.
Decision dates by country: AT: 2026-03-01, BE: 2026-02-24, BG: 2026-03-02, HU: 2026-02-25, LT: 2026-02-24, NO: 2026-02-25, ES: 2026-02-27, GR: 2026-02-25, PL: 2026-02-26, SK: 2026-02-24, CZ: 2026-02-24, IT: 2026-02-25, FR: 2026-02-24, NL: 2026-02-26, DE: 2026-02-25

Condition(s): Immune system diseases
Product: Duvakitug, Matched placebo for test product

Primary endpoint: Co-primary endpoints US/FDA: Pivotal Maintenance Sub-Study Cohort 1 • Proportion of participants achieving clinical remission (CDAI) at Week 40, Co-primary endpoints US/FDA: Pivotal Maintenance Sub-Study Cohort 1 • Proportion of participants achieving Endoscopic Response (SES-CD) at Week 40, Co-primary endpoints EU/EMA: Pivotal Maintenance Sub-Study Cohort 1 • Proportion of participants achieving clinical remission per PRO-2 at Week 40, Co-primary endpoints EU/EMA: Pivotal Maintenance Sub-Study Cohort 1 • Proportion of participants achieving Endoscopic Response (SES-CD) at Week 40
Endpoint(s): Pivotal Maintenance Sub-Study Cohort 1: Proportion of participants achieving CDAI clinical response Week 40, Pivotal Maintenance Sub-Study Cohort 1: Proportion of participants achieving SES-CD endoscopic remission at Week 40, US/FDA Pivotal Maintenance Sub-Study Cohort 1: Proportion of participants achieving CDAI clinical remission and endoscopic remission at Week 40, EU/EMA Pivotal Maintenance Sub-Study Cohort 1: Proportion of participants achieving PRO-2 clinical remission and endoscopic remission at Week 40, US/FDA Pivotal Maintenance Sub-Study Cohort 1: Proportion of participants achieving PRO-2 clinical remission at Week 40, EU/EMA Pivotal Maintenance Sub-Study Cohort 1: Proportion of participants achieving CDAI clinical remission at Week 40, US/FDA Pivotal Maintenance Sub-Study Cohort 1: Proportion of participants achieving corticosteroids free CDAI clinical remission at Week 40, EU/EMA Pivotal Maintenance Sub-Study Cohort 1: Proportion of participants achieving corticosteroids free PRO-2 remission at Week 40, Pivotal Maintenance Sub-Study Cohort 1: Proportion of participants achieving ulcer-free endoscopy (in the subset of participants with ulcers at Baseline) at Week 40, US/FDA Pivotal Maintenance Sub-Study Cohort 1: Proportion of participants achieving clinical remission per CDAI at Week 40 in the subset of participants with clinical remission per CDAI at Week 0 (maintenance of clinical remission per CDAI), EU/EMA Pivotal Maintenance Sub-Study Cohort 1: Proportion of participants achieving clinical remission per PRO-2 at Week 40 in the subset of participants with clinical remission per PRO-2 at Week 0 (maintenance of clinical remission per PRO-2), Pivotal Maintenance Sub-Study Cohort 1: Change from Baseline in PROMIS-Fatigue Short Form 7a T-score at Week 40, Pivotal Maintenance Sub-Study Cohort 1: Change from Baseline in IBDQ total score at Week 40, Pivotal Maintenance Sub-Study Cohort 1: Proportion of participants with no bowel urgency by NRS at Week 40, Pivotal Maintenance Sub-Study Cohort 1: Incidence of CD related hospitalization by Week 40, Pivotal Maintenance Sub-Study Cohort 1: Serum concentrations of duvakitug measured over time, Pivotal Maintenance Sub-Study Cohort 1: Incidence of treatment- emergent antidrug antibody (ADA) against duvakitug, Pivotal Maintenance Sub-Study Cohort 1: Incidence of treatment- emergent adverse events (TEAEs), treatment-emergent adverse events of special interest (TEAESIs), treatment-emergent serious adverse events (TESAEs) and TEAEs leading to permanent study intervention discontinuation, Open-Label Extension Sub-Study: Incidence of TEAEs, TEAESIs, TESAEs, and TEAEs leading to permanent study intervention discontinuation

Source: https://euclinicaltrials.eu/ctis-public/view/2025-521037-86-00